EU clinical trial 2024-516468-27-00: Is adding Cilostazol to nimodipine improving neurological outcome of patients with Aneurysmal Subarachnoid Hemorrhage? A randomized, double blind, placebo-controlled trial
Protocol code: D24-P009
Sponsor: Groupe Hospitalier Universitaire Paris Psychiatrie Et Neuroscience (Hospital/Clinic/Other health care facility). Phase: Therapeutic confirmatory (Phase III). Countries: France (authorised, recruiting).
Therapeutic area(s): Diseases [C] - Nervous System Diseases [C10]
Gender: Female, Male. Age: 18-64 years, 65+ years. Enrolment: 630.
Status: Authorised, recruiting. Start date (EU): 2026-04-07. Decision date: 2025-05-07. Results received: No. Last updated: 2025-12-08.

Condition(s): Aneurysmal Subarachnoid Hemorrhage
Product: Cilostazol-Elpen 100 mg Tabletten, Placebo de Cilostazol-Elpen 100mg, comprimé

Primary endpoint: Modified Rankin Scale (mRS) assessed at 6 months in a structured face-to-face interview. Favorable outcome is defined by an mRS score 0 to 2, and unfavorable outcome by a mRS from 3 to 6. (Appendix 1)
Endpoint(s): The main pitfall of the modified Rankin Scale is the overrating of patients that develop cognitive impairment. We thus chose to assess separately cognitive impairment with using specific scales, including the MOCA, ADL and IADL. The SAHOT (SAH-outcome tool) will be finally assessed, as it has been recently developed and validated but not yet commonly used as the mRS (18)., Other generic morbidity criterion will be used: Length of Intensive Care Unit (ICU) stay. Length of hospital stay. 28-day mortality, Delayed cerebral ischemia, defined by the appearance of a focal neurological deficit or a decrease of at least 2 points on the Glasgow Coma Scale, which is not apparent immediately after surgical or endovascular treatment of the aneurysm and not attributable to other causes., Short-term course of angiographically defined vasospasm, defined as a reduction in the caliber of proximal cerebral vessels observed by CT, MRI, or catheter angiography, Cerebral infarctions, defined by a diagnosis of cerebral infarction made by CT scan or MRI within 6 weeks, or on the last CT scan or MRI performed before death within 6 weeks, or at autopsy, not present on the CT scan or MRI between 24 and 48 hours after early aneurysm occlusion, Occurrence of DCI during the ICU stay, Occurrence of cerebral vasospasm on a brain imaging on digitally substracted angiography (DSA) or Magnetic resonance/computed tomography angiogram (MR/CTA) performed upon clinical signs of delayed cerebral ischemia or severe impairment of cerebral blood velocity in transcranial doppler, Occurrence of new cerebral infarcts, Occurrence of cilostazol-related major adverse events, including: arrythmia, abnormal bleeding and allergy., Occurrence of cilostazol-related minor adverse events include: tachycardia, fever, fainting, nausea, vomiting and stomach pain.

Source: https://euclinicaltrials.eu/ctis-public/view/2024-516468-27-00